EU clinical trial 2023-505477-33-00: A Phase 3, Randomized, Double-Blind Study Comparing Risankizumab to Placebo in Subjects with Active Psoriatic Arthritis Including Those Who Have a History of Inadequate Response or Intolerance to Biologic Therapy(ies) (KEEPsAKE 2)
Protocol code: M15-998
Sponsor: AbbVie Deutschland GmbH & Co. KG (Pharmaceutical company). Phase: Therapeutic confirmatory (Phase III). Countries: Poland (ongoing, recruitment ended), Hungary (ongoing, recruitment ended), Belgium (ongoing, recruitment ended), Estonia (ongoing, recruitment ended), Italy (ended), Greece (ended), Denmark (ongoing, recruiting), Spain (ongoing, recruitment ended), Portugal (ongoing, recruitment ended), Germany (ended).
Therapeutic area(s): Diseases [C] - Skin and Connective Tissue Diseases [C17]; Diseases [C] - Immune System Diseases [C20]
Gender: Female, Male. Age: 18-64 years, 65+ years. Enrolment: 133.
Start date (EU): 2019-06-18. Decision date: 2024-02-29. Results received: No. Last updated: 2025-11-20.
Decision dates by country: PL: 2024-04-02, DK: 2024-02-29, BE: 2024-03-11, IT: 2024-03-22, EE: 2024-03-05, GR: 2024-04-09, DE: 2024-02-29, PT: 2024-02-29, HU: 2024-03-01, ES: 2024-03-01

Condition(s): Psoriatic Arthritis
Product: Placebo for Risankizumab Solution for Injection 90 mg/mL, Risankizumab, ABBV-066

Primary endpoint: The primary endpoint is the proportion of subjects achieving American College of Rheumatology (ACR)20 response at Week 24.
Endpoint(s): Change from Baseline in Health Assessment Questionnaire-Disability Index (HAQ-DI) at Week 24., Proportion of subjects achieving Psoriasis Area Severity Index (PASI) 90 response at Week 24 (in the subset of subjects with a body surface area (BSA) ≥ 3% at Baseline., Proportion of subjects achieving ACR20 at Week 16., Proportion of subjects achieving Minimal Disease Activity (MDA) at Week 24., Change from Baseline in 36-Item Short Form Health Survey (SF-36) Physical Component Summary (PCS) at Week 24., Change from Baseline in Functional Assessment of Chronic Illness Therapy-Fatigue (FACIT Fatigue) Questionnaire at Week 24., Proportion of subjects achieving ACR50 response at Week 24., Proportion of subjects achieving ACR70 response at Week 24., Proportion of subjects with resolution of enthesitis (LEI = 0) at Week 24 in subjects with enthesitis at Baseline., Proportion of subjects with resolution of dactylitis (LDI = 0) at Week 24 in subjects with dactylitis at Baseline

Source: https://euclinicaltrials.eu/ctis-public/view/2023-505477-33-00